EU clinical trial 2022-501760-17-00: Longitudinal study of clinical outcome measures in adult patients with Spinal Muscular Atrophy (SMA) treated with Risdiplam.
Protocol code: version 4.0
Sponsor: UZ Leuven (Hospital/Clinic/Other health care facility). Phase: Therapeutic confirmatory (Phase III). Countries: Belgium (ended).
Therapeutic area(s): Diseases [C] - Nervous System Diseases [C10]
Gender: Female, Male. Age: 18-64 years, 65+ years. Enrolment: 20.
Status: Ended. Start date (EU): 2023-06-13. End date (EU): 2024-10-02. Decision date: 2022-11-28. Results received: Yes. Last updated: 2023-04-24.
Decision dates by country: BE: 2023-01-11

Condition(s): Spinal Muscular Atrophy (SMA)
Product: Evrysdi 0.75 mg/mL powder for oral solution

Primary endpoint: The primary endpoint of this study is: The change in clinical and functional outcome measures in adult patients with SMA type 2 or 3 or patients with up to 4 SMN2-gene copies treated with Risdiplam from baseline to 24 months.
Endpoint(s): The secondary endpoints of this study are: Quantitative changes of biomarkers in blood (neurofilament light chain and neurofilament heavy chain) in adult patients with SMA type 2 or 3 or patients with up to 4 SMN2-gene copies treated with Risdiplam from baseline to 24 months, AND To assess the safety and tolerability of Risdiplam treatment.

Source: https://euclinicaltrials.eu/ctis-public/view/2022-501760-17-00